EU clinical trial 2022-501438-46-00: NAC Attack, A Phase III, Multicenter, Randomized, Parallel, Double Masked, Placebo-Controlled Study Evaluating the Efficacy and Safety of Oral N-Acetylcysteine in Patients with Retinitis Pigmentosa
Sponsor: Johns Hopkins University (Educational Institution). Phase: Therapeutic confirmatory (Phase III). Countries: Netherlands (ongoing, recruitment ended), Austria (ongoing, recruitment ended), Germany (ongoing, recruitment ended).
Therapeutic area(s): Diseases [C] - Eye Diseases [C11]
Gender: Female, Male. Age: 18-64 years. Enrolment: 120.
Status: Ongoing, recruitment ended. Start date (EU): 2024-01-22. Decision date: 2023-04-06. Results received: No. Last updated: 2023-12-11.
Decision dates by country: NL: 2023-04-06, AT: 2023-12-11, DE: 2023-11-14

Condition(s): Retinitis Pigmentosa
Product: Fluimucil long 600 mg Brausetabletten, Acetylcysteine 600 mg PLACEBO, effervescent tablets

Primary endpoint: The primary efficacy endpoint is to determine if the progressive loss in EZ width assessed as the cumulative loss of EZ (calculated as the area under the curve, AUC) between baseline and M45 is significantly smaller in eyes of participants taking NAC 1800 mg bid compared with eyes of participants taking placebo. EZ width will be measured on a spectral domain-optical coherence tomography (SD-OCT) scan through the fovea.
Endpoint(s): The secondary efficacy endpoints are to assess the relative efficacy in eyes of participants taking NAC 1800 mg bid compared with eyes of participants taking placebo on the basis of the following endpoints: • Change from baseline mean macular sensitivity measured by microperimetry (MP) at M45. • Change from baseline in BCVA measured by Early Treatment Diabetic Retinopathy Study (ETDRS) protocol at M45.

Source: https://euclinicaltrials.eu/ctis-public/view/2022-501438-46-00